EU clinical trial 2023-510159-53-01: Treatment of peritoneal dissemination in stomach cancer patients with cytoreductive surgery and hyperthermic intraperitoneal chemotherapy; PERISCOPE-2
Protocol code: NL56123.031.15
Sponsor: Het Nederlands Kanker Instituut-Antoni van Leeuwenhoek Ziekenhuis Stichting (Hospital/Clinic/Other health care facility). Phase: Therapeutic exploratory (Phase II). Countries: Sweden (ongoing, recruitment ended), Finland (ongoing, recruitment ended), Denmark (ongoing, recruitment ended), Netherlands (ongoing, recruitment ended).
Therapeutic area(s): Diseases [C] - Digestive System Diseases [C06]
Gender: Female, Male. Age: 18-64 years, 65+ years. Enrolment: 226.
Status: Ongoing, recruitment ended. Start date (EU): 2017-09-28. Decision date: 2025-01-13. Results received: No. Last updated: 2025-01-22.
Decision dates by country: SE: 2025-01-13, FI: 2025-01-16, DK: 2025-01-22, NL: 2025-01-13

Condition(s): peritoneal dissemination in stomach cancer patients
Product: TAXOTERE 20 mg/0.5 ml concentrate and solvent for solution for infusion, Oxaliplatine Accord 5 mg/ml concentraat voor oplossing voor infusie

Primary endpoint: Overall survival
Endpoint(s): Progression free survival, Treatment-related toxicity, Costs and resource use, Quality of life, Genetic profiles related to tumour response (optional), pharmacokinetics and penetration depth of oxaliplatin and docetaxel (optional)

Source: https://euclinicaltrials.eu/ctis-public/view/2023-510159-53-01